EU clinical trial 2025-522913-45-00: A study to test how well different doses of BI 3820768 are tolerated by people with advanced cancer (solid tumours)
Protocol code: 2001-0001
Sponsor: Boehringer Ingelheim International GmbH, Boehringer Ingelheim Espana S.A. (Pharmaceutical company). Phase: Human Pharmacology (Phase I)- Other. Countries: Spain (ongoing, recruiting), France (ongoing, recruiting), Belgium (authorised, recruiting), Germany (ongoing, recruiting).
Therapeutic area(s): Diseases [C] - Neoplasms [C04]
Gender: Female, Male. Age: 18-64 years, 65+ years. Enrolment: 102.
Start date (EU): 2026-05-21. Decision date: 2026-04-20. Results received: No. Last updated: 2026-08-07.
Decision dates by country: FR: 2026-04-22, BE: 2026-04-20, DE: 2026-04-23, ES: 2026-04-27

Condition(s): Advanced relapsed or refractory ovarian cancer, Advanced relapsed or refractory germ cell tumours, Advanced relapsed or refractory endometrial cancer

Source: https://euclinicaltrials.eu/ctis-public/view/2025-522913-45-00